EU clinical trial 2023-509270-37-00: A Phase 1/2 Study of Oral LOXO-305 in Patients with Previously Treated Chronic Lymphocytic Leukemia/Small Lymphocytic Lymphoma (CLL/SLL) or Non-Hodgkin Lymphoma (NHL)
Protocol code: LOXO-BTK-18001 BRUIN
Sponsor: Loxo Oncology Inc. (Pharmaceutical company). Phase: Phase I and Phase II (Integrated)- First administration to humans. Countries: Poland (ended), France (ended), Italy (ended).
Therapeutic area(s): Diseases [C] - Hemic and Lymphatic Diseases [C15]
Gender: Female, Male. Age: 18-64 years, 65+ years. Enrolment: 37.
Status: Ended. Start date (EU): 2019-10-10. End date (EU): 2025-11-21. End date: 2025-12-23. Decision date: 2024-06-14. Results received: No. Last updated: 2025-10-15.
Decision dates by country: PL: 2024-06-18, IT: 2024-06-19, FR: 2024-06-14

Condition(s): Chronic Lymphocytic Leukemia/Small Lymphocytic Lymphoma (CLL/SLL) and Non-Hodgkin Lymphoma (NHL)"

Primary endpoint: Primary Endpoint Phase 1 Monotherapy MTD/RP2D, Primary Endpoint Phase 2 Monotherapy "Each Cohort: ORR by appropriate disease-defined criteria and assessed by Independent Review Committee (IRC), Primary Endpoint Phase 1b Combinations "Safety of pirtobrutinib in the specified combinations as described by AEs and SAEs, changes in hematology and blood chemistry values, assessments of physical examinations, vital signs, and ECGs
Endpoint(s): Ph 1 Monotherapy • AEs and SAEs, changes in hematology and blood chemistry values, assessments of physical examinations, vital signs, and ECGs • Plasma concentration of pirtobrutinib and PK parameters including, but not limited to, area under the concentration versus time curve (AUC), maximum drug concentration (Cmax), time to maximum plasma concentration (Tmax), terminal elimination half-life (T1/2), and degree of accumulation • ORR by Investigator, Ph 2 Monotherapy • ORR (by Investigator), best overall response, duration of response, PFS (by Investigator and IRC) • Overall survival • AEs and SAEs, hematology and blood chemistry values, physical examinations, vital signs, and ECGs • Plasma concentration of pirtobrutinib and PK parameters • Symptomatic response: MCL patients • Functional response: MCL patients, Exp: • Efficacy and safety based on PK • Rate of MRD (-) • Relationship: prognostic markers, efficacy, and safety • Correlation: molecular testing and diagnostic development • Identity of BTK and PLCg2 gene mutations and activated oncogenic pathways and PD response from blood, bone marrow, tumor/lymph node biopsies • Symptomatic response: CLL/SLL, NHL • Functional response: CLL/SLL, NHL • Time to worsening (TtW) cancer-related symptoms, TtW physical function, pain, role function, Phase 1b Combinations "• Plasma concentration of pirtobrutinib, venetoclax, and rituximab when appropriate, and PK parameters, including, but not limited to, AUC, Cmax, Tmax, T1/2, and degree of accumulation • ORR, BOR, DOR, PFS by Investigator, Exp. Phase 1b Combinations

Source: https://euclinicaltrials.eu/ctis-public/view/2023-509270-37-00